EU clinical trial 2023-507720-23-00: A Study to assess the safety and potential use of GEH121224 (18F) Injection to visualise HER2-Receptor expression using PET imaging in patients with Metastatic Breast Cancer
Protocol code: GE-226-006
Sponsor: GE Healthcare Limited (Pharmaceutical company). Phase: Phase I and Phase II (Integrated)- Other. Countries: Sweden (ended).
Therapeutic area(s): Analytical, Diagnostic and Therapeutic Techniques and Equipment [E] - Investigative Techniques [E05]
Gender: Female. Age: 18-64 years, 65+ years. Enrolment: 43.
Status: Ended. Start date (EU): 2024-11-15. End date (EU): 2025-10-03. Decision date: 2024-10-01. Results received: No. Last updated: 2025-06-27.

Condition(s): Metastatic breast cancer

Source: https://euclinicaltrials.eu/ctis-public/view/2023-507720-23-00